EU clinical trial 2025-521783-35-00: Study to Learn How Safe EV25 is and the Amount of EV25 in the Body Over a Period of Time, When Taken [CCI] as a Dry Powder via the Nose by Adult Healthy People
Protocol code: EV-FLU-CL-03
Sponsor: Eradivir Inc. (Pharmaceutical company). Phase: Human Pharmacology (Phase I)- Other. Countries: Belgium (ended).
Therapeutic area(s): Diseases [C] - Virus Diseases [C02]
Gender: Female, Male. Age: 18-64 years, 65+ years. Enrolment: 16.
Status: Ended. Start date (EU): 2025-07-10. End date (EU): 2025-09-23. Decision date: 2025-07-03. Results received: No. Last updated: 2025-07-03.

Condition(s): Influenza virus

Source: https://euclinicaltrials.eu/ctis-public/view/2025-521783-35-00